EU clinical trial 2025-520521-21-00: A Phase III, Randomised, Double-Blind, Placebo-Controlled, Parallel-Group Study to Assess the Effect of AZD0780 on Low-Density Lipoprotein Cholesterol in Patients With Elevated Low-Density Lipoprotein Cholesterol and Clinical Atherosclerotic Cardiovascular Disease or at Risk for a First Atherosclerotic Cardiovascular Disease Event
Protocol code: D7960C00012
Sponsor: AstraZeneca AB (Pharmaceutical company). Phase: Therapeutic confirmatory (Phase III). Countries: Bulgaria (ongoing, recruitment ended), Poland (ongoing, recruitment ended), Slovakia (ongoing, recruitment ended), Hungary (ongoing, recruitment ended), Czechia (ongoing, recruitment ended), Spain (ongoing, recruitment ended), Germany (ongoing, recruitment ended).
Therapeutic area(s): Diseases [C] - Cardiovascular Diseases [C14]
Gender: Female, Male. Age: 18-64 years, 65+ years. Enrolment: 780.
Status: Ongoing, recruitment ended. Start date (EU): 2025-09-02. Decision date: 2025-08-18. Results received: No. Last updated: 2026-04-24.
Decision dates by country: BG: 2025-08-21, HU: 2025-08-21, SK: 2025-08-18, PL: 2025-08-22, ES: 2025-08-22, DE: 2025-08-19, CZ: 2025-08-19

Condition(s): Hyperlipidemia, Atherosclerotic cardiovascular disease
Product: AZD0780, AZD0780 Placebo

Primary endpoint: Relative change in LDL-C from baseline to 12 weeks
Endpoint(s): Relative change in LDL-C from baseline to 12 weeks (in patients on background statin therapy at baseline), Indicator for LDL-C < 70 mg/dL (< 1.8 mmol/L) at 12 weeks, Indicator for LDL-C < 55 mg/dL (< 1.4 mmol/L) at 12 weeks, Relative change in LDL-C from baseline to 28 weeks, Relative change in LDL-C from baseline to 52 weeks, Relative change in Apo B from baseline to 12 weeks, Relative change in non-HDL-C from baseline to 12 weeks, Relative change in total cholesterol from baseline to 12 weeks, Relative change in Lp(a) from baseline to 12 weeks

Source: https://euclinicaltrials.eu/ctis-public/view/2025-520521-21-00